EU clinical trial 2024-518267-35-00: Atorvastatinbehandling til patienter med de Philadelphia-negative kronisk myeloproliferative neoplasier - essentiel trombocytose, polycythemia vera og præfibrotisk myelofibrose.
Protocol code: HH007
Sponsor: Region Sjaelland (Hospital/Clinic/Other health care facility). Phase: Therapeutic exploratory (Phase II). Countries: Denmark (ongoing, recruiting).
Therapeutic area(s): Diseases [C] - Hemic and Lymphatic Diseases [C15]
Gender: Female, Male. Age: 18-64 years, 65+ years. Enrolment: 40.
Status: Ongoing, recruiting. Start date (EU): 2025-06-10. Decision date: 2024-10-29. Results received: No. Last updated: 2026-05-06.

Condition(s): Blod cancer
Product: Atorvastatin 40mg Film-Coated Tablets, Atorvastatin 20mg Film-Coated Tablets, Atorvastatin 80mg Film-Coated Tablets

Primary endpoint: 1. Inflammatory parameters: hs-CRP, inflammatory cytokines, leukocyte count, platelet count and neutrophil/lymphocyte ratio (NLR).

Source: https://euclinicaltrials.eu/ctis-public/view/2024-518267-35-00